EU clinical trial 2024-511449-21-00: Phase 2, Single-arm, Open-label Study of DS1062a in Advanced or Metastatic Non-small Cell Lung Cancer with Actionable Genomic Alterations and Progressed on or After Applicable Targeted Therapy and Platinumbased Chemotherapy (TROPION-Lung05)
Protocol code: DS1062-A-U202
Sponsor: Daiichi Sankyo Inc. (Pharmaceutical company). Phase: Therapeutic exploratory (Phase II). Countries: Netherlands (ended), France (ended), Spain (ended).
Therapeutic area(s): Diseases [C] - Neoplasms [C04]
Gender: Female, Male. Age: 18-64 years. Enrolment: 6.
Status: Ended. Start date (EU): 2021-03-25. End date (EU): 2026-01-21. End date: 2026-02-04. Decision date: 2024-07-11. Results received: No. Last updated: 2025-12-15.
Decision dates by country: FR: 2024-07-18, ES: 2024-07-11, NL: 2024-07-12

Condition(s): Advanced or Metastatic Non-small Cell Lung Cancer (NSCLC)
Product: Datopotamab deruxtecan

Primary endpoint: Overall response rate (ORR) - Defined as the proportion of subjects who achieved a Best overall response (BOR) of confirmed Complete response (CR) or confirmed Partial response (PR).
Endpoint(s): 1) Efficacy - Duration of response (DoR) - defined as the time from the date of the first documentation of response (confirmed CR or confirmed PR) to the date of the first documentation of disease progression (PD) or death due to any cause, whichever occurs first., - The best percentage change in the Sum of diameters (SoD) of measurable tumors is defined as the percentage change in the smallest SoD from all post-baseline tumor assessments, taking as reference the baseline SoD., - Disease control rate (DCR) - defined as the proportion of subjects who achieved a BOR of confirmed CR, confirmed PR, or SD (stable disease)., - Clinical benefit rate (CBR) - defined as the proportion of subjects who achieved a BOR of confirmed CR, confirmed PR, or an SD that lasts for at least 180 days., - Progression-free survival (PFS) - defined as the time from the start of study treatment to the earlier of the dates of the first documentation of PD or death due to any cause., - Time to response (TTR) - defined as the time from the start of study treatment to the date of the first documentation of objective response (confirmed CR or confirmed PR) in responding subjects., - Overall response rate (ORR) - defined as the proportion of subjects who achieved a BOR of confirmed CR or confirmed PR., - Overall survival (OS) - defined as the time from the start of study treatment to the date of death due to any cause., 2) Safety - Treatment-emergent adverse event (TEAEs), Serious adverse event (SAEs), Adverse event of special interest (AESIs), Eastern Cooperative Oncology Group performance status (ECOG PS), vital sign measurements, standard clinical laboratory parameters (hematology, serum chemistry, and urinalysis), ECG parameters, Echocardiogram/multigated acquisition (ECHO/MUGA) scan findings, and ophthalmologic findings. (cont.), (cont.) AEs will be coded using the most current version of MedDRA. AEs and laboratory test results will be graded using the National Cancer Institute-Common Terminology Criteria for Adverse Events (NCI-CTCAE) v5.0., 3) PK - Plasma concentrations at each time point and PK parameters (Cmax, Tmax, AUClast, AUCtau. If data permit: AUCinf, t1/2, CL, Vss, Vz, and Kel) of DS-1062a, total anti-TROP2 antibody, and MAAA-1181a (released drug) in the full PK sampling cohort., 4) Immunogenicity Antidrug-antibody (ADA) prevalence: the proportion of subjects who are ADA positive at any point in time (including pre-existing ADA at baseline and treatment-emergent ADA). ADA incidence: the proportion of subjects having treatment-emergent ADA. Titer and neutralizing antibodies will be determined when ADA is positive.

Source: https://euclinicaltrials.eu/ctis-public/view/2024-511449-21-00